EU clinical trial 2024-519827-16-00: A Randomized, Open-Label, Controlled Phase 3 Study Comparing Daratumumab, Lenalidomide and Dexamethasone Induction followed by Linvoseltamab Versus continued Daratumumab, Lenalidomide, and Dexamethasone in Newly Diagnosed Transplant Ineligible Multiple Myeloma Patients
Protocol code: EMN39
Sponsor: European Myeloma Network B.V., Emn Trial Office S.r.l. Impresa Sociale (Patient organisation/association, Laboratory/Research/Testing facility). Phase: Therapeutic confirmatory (Phase III). Countries: Norway (ongoing, recruiting), Denmark (ongoing, recruiting), Spain (ongoing, recruiting), Sweden (ongoing, recruiting), Austria (ongoing, recruiting), Netherlands (authorised, recruiting), Greece (ongoing, recruiting), Germany (ongoing, recruiting), Italy (ongoing, recruiting), Belgium (authorised, recruiting), Portugal (authorised, recruiting), Estonia (ongoing, recruiting), Croatia (ongoing, recruiting), Ireland (ongoing, recruiting), Czechia (ongoing, recruiting), Finland (ongoing, recruiting).
Therapeutic area(s): Diseases [C] - Neoplasms [C04]
Gender: Female, Male. Age: 18-64 years, 65+ years. Enrolment: 713.
Start date (EU): 2025-09-30. Decision date: 2025-09-01. Results received: No. Last updated: 2026-08-05.
Decision dates by country: HR: 2025-09-08, IE: 2025-09-05, IT: 2025-10-07, BE: 2025-09-01, DK: 2025-09-02, FI: 2025-10-10, GR: 2025-11-04, NO: 2025-09-03, SE: 2025-09-08, NL: 2025-09-02, CZ: 2025-09-03, PT: 2025-10-15, EE: 2025-09-04, ES: 2025-09-04, AT: 2025-09-05, DE: 2025-09-04

Condition(s): Newly Diagnosed Transplant Ineligible Multiple Myeloma Patients
Product: Lenalidomide Accord 10 mg hard capsules, Dexamethason CF 20 mg/ml, injectievloeistof, Dexamethason Teva 4 mg, tabletten, Revlimid 10 mg hard capsules, Lenalidomid STADA 10 mg Hartkapseln, DARZALEX 1800 mg solution for injection, Revlimid 25 mg hard capsules, Lenalidomid STADA 5 mg Hartkapseln, Lenalidomid AL 15 mg Hartkapseln, Lenalidomid STADA 25 mg Hartkapseln, Revlimid 5 mg hard capsules, Revlimid 15 mg hard capsules, Lenalidomid STADA 15 mg Hartkapseln, LYNOZYFIC 5 mg concentrate for solution for infusion, Lenalidomid AL 10 mg Hartkapseln, LYNOZYFIC 200 mg concentrate for solution for infusion, Lenalidomid AL 5 mg Hartkapseln, Lenalidomid AL 25 mg Hartkapseln, Lenalidomide Accord 15 mg hard capsules, Lenalidomide Accord 25 mg hard capsules, Lenalidomide Accord 5 mg hard capsules

Primary endpoint: MRD negative CR status at 10-5 (as measured in BM by clonoSEQ assay) per IMWG criteria (S. Kumar et al., 2016) as determined by BICR, PFS per IMWG response criteria (S. Kumar et al., 2016) as determined by BICR, defined as the time from the date of randomization to the date of first documented evidence of progressive disease or death, whichever occurs first
Endpoint(s): • The key secondary endpoint is overall survival (OS) from time of randomization.

Source: https://euclinicaltrials.eu/ctis-public/view/2024-519827-16-00